EU clinical trial 2024-513217-12-00: Immune induction strategies to improve response to immune checkpoint blockade in triple negative breast cancer (TNBC) patients: the TONIC-2 trial
Sponsor: Het Nederlands Kanker Instituut-Antoni van Leeuwenhoek Ziekenhuis Stichting (Hospital/Clinic/Other health care facility). Phase: Therapeutic exploratory (Phase II). Countries: Netherlands (ongoing, recruitment ended).
Therapeutic area(s): Diseases [C] - Neoplasms [C04]
Gender: Female, Male. Age: 18-64 years, 65+ years. Enrolment: 34.
Status: Ongoing, recruitment ended. Start date (EU): 2020-02-04. Decision date: 2025-01-13. Results received: No. Last updated: 2025-01-13.

Condition(s): Triple negative breast cancer (TNBC) with metastatic disease
Product: OPDIVO 10 mg/mL concentrate for solution for infusion., Cisplatine 1 mg/ml PCH, concentraat voor oplossing voor infusie

Primary endpoint: Progression-free survival as measured by the proportion of patients free of progression after 6 cycles of nivolumab (PFS1: time from randomization to tumor progression or death from any cause) according to RECIST1.1
Endpoint(s): Response as measured by the objective response rate (ORR: complete responses or partial responses) according to iRECIST and RECIST1.1, Clinical benefit as measured by the clinical benefit rate (CBR) according to RECIST 1.1 and iRECIST, PFS1 according to RECIST 1.1 and iRECIST, Overall survival (OS: time from nivolumab initiation to death from any cause), Percentage of patients with toxicity (CTCAE v5.0) and immune-related toxicity, PFS as measured by the proportion of patients free of progression after 6 cycles of nivolumab (PFS2: time from randomization to tumor progression or death from any cause). Progression as defined by RECIST 1.1 and iRECIST will be used

Source: https://euclinicaltrials.eu/ctis-public/view/2024-513217-12-00